EU clinical trial 2024-512626-28-00: A Phase 3, Multinational, Randomized, Double-Blind, Placebo-Controlled Systemic Gene Transfer Therapy Study to Evaluate the Safety and Efficacy of SRP-9001 in Non-Ambulatory and Ambulatory Subjects With Duchenne Muscular Dystrophy (ENVISION)
Protocol code: SRP-9001-303
Sponsor: Sarepta Therapeutics Inc. (Pharmaceutical company). Phase: Therapeutic confirmatory (Phase III). Countries: Germany (suspended), Belgium (temporarily halted), Sweden (temporarily halted), France (suspended), Italy (temporarily halted), Spain (temporarily halted).
Therapeutic area(s): Diseases [C] - Musculoskeletal Diseases [C05]
Gender: Male. Age: 0-17 years, 18-64 years. Enrolment: 70.
Start date (EU): 2024-03-28. Decision date: 2024-09-12. Results received: No. Last updated: 2026-08-07.
Decision dates by country: FR: 2024-09-17, BE: 2024-09-12, DE: 2024-09-17, SE: 2024-09-16, IT: 2024-09-30, ES: 2024-10-15

Condition(s): Duchenne Muscular Dystrophy
Product: Saline, 0.9% sodium chloride solution IV infusion marketed authorized will be used as the placebo and will be supplied by the site. the SmPC previously authorized are Country specific. for Belgium, Spain and Sweden per local requirements under CTDs no SmPCs were submitted., Delandistrogene moxeparvovec-rokl

Primary endpoint: Part 1: Change From Baseline in the Total Score of Performance of Upper Limb (PUL) (Version 2.0) at Week 72
Endpoint(s): Part 1: Change From Baseline in Percent Predicted Forced Vital Capacity (FVC) at Week 72, Part 1: Change From Baseline in Percent Predicted Peak Expiratory Flow (PEF) at Week 72, Part 1: Quantity of Delandistrogene Moxeparvovec Dystrophin Expression at Week 12 as Measured by Western Blot, Part 1: Change From Baseline in Patient-Reported Outcomes Measurement Information (PROMIS) Score in Upper Extremity Function to Week 72, Number of Participants with a Treatment Emergent Adverse Event (TEAE), Adverse Event of Special Interest (AESI), and Serious Adverse Event (SAE), Part 1 (For Cohort 2 Only): Change From Baseline in the North Star Ambulatory Assessment (NSAA) Total Score at Week 72, Part 1: Change From Baseline in Global Circumferential Strain as Measured by Cardiac MRI at Week 72, Part 1: Change From Baseline in PUL (Version 2.0) Middle Domain Score at Week 72.

Source: https://euclinicaltrials.eu/ctis-public/view/2024-512626-28-00